EU clinical trial 2023-506291-28-00: CIME - Combination of Immune checkpoint in locally advanced or metastatic MSI/dMMR Esogastric adenocarcinomas : A multicenter, randomised, comparative, open-label Phase III aiming to compare the survival of patients with locally advanced or metastatic MSI/dMMR Esogastric adenocarcinomas treated by a combination of Immune checkpoint inhibitors (botensilimab + balstilimab) versus the standard of care (FOLFOX/XELOX + nivolumab)
Protocol code: CIME/ET23-185
Sponsor: Centre Leon Berard (Hospital/Clinic/Other health care facility). Phase: Therapeutic confirmatory (Phase III). Countries: France (ongoing, recruiting).
Therapeutic area(s): Diseases [C] - Neoplasms [C04]; Diseases [C] - Pathological Conditions, Signs and Symptoms [C23]
Gender: Female, Male. Age: 18-64 years, 65+ years. Enrolment: 132.
Status: Ongoing, recruiting. Start date (EU): 2026-03-02. Decision date: 2024-02-22. Results received: No. Last updated: 2026-04-29.
Decision dates by country: FR: 2024-05-03

Condition(s): Patient with locally advanced/metastatic, MSI-H/dMMR gastric cancer
Product: OXALIPLATINE WINTHROP 5 mg/ml, solution à diluer pour perfusion, FLUOROURACILE PFIZER 50 mg/mL, solution à diluer pour perfusion, FLUOROURACILE PFIZER 50 mg/mL, solution à diluer pour perfusion, FLUOROURACILE PFIZER 50 mg/mL, solution à diluer pour perfusion, OPDIVO 10 mg/mL concentrate for solution for infusion., OPDIVO 10 mg/mL concentrate for solution for infusion., FLUOROURACILE PFIZER 50 mg/mL, solution à diluer pour perfusion, FLUOROURACILE PFIZER 50 mg/mL, solution à diluer pour perfusion, FLUOROURACILE PFIZER 50 mg/mL, solution à diluer pour perfusion, BOTENSILIMAB, FLUOROURACILE PFIZER 50 mg/mL, solution à diluer pour perfusion, BALSTILIMAB, FLUOROURACILE PFIZER 50 mg/mL, solution à diluer pour perfusion, OPDIVO 10 mg/mL concentrate for solution for infusion., FLUOROURACILE PFIZER 50 mg/mL, solution à diluer pour perfusion, FLUOROURACILE PFIZER 50 mg/mL, solution à diluer pour perfusion, OXALIPLATINE WINTHROP 5 mg/ml, solution à diluer pour perfusion, OXALIPLATINE WINTHROP 5 mg/ml, solution à diluer pour perfusion, FLUOROURACILE PFIZER 50 mg/mL, solution à diluer pour perfusion, CAPECITABINE, FLUOROURACILE PFIZER 50 mg/mL, solution à diluer pour perfusion, OPDIVO 10 mg/mL concentrate for solution for infusion., FLUOROURACILE PFIZER 50 mg/mL, solution à diluer pour perfusion

Primary endpoint: Overall Survival
Endpoint(s): PFS, Objective response rate after 16 weeks of treatment (ORR-16W) and duration of response (DoR) as per RECIST V1.1, Adverse events (AEs), drugs related AEs, drugs related AE leading to dose reduction or discontinuation during treatment, SAE and SUSAR, immune-related AE graded according to NCI-CTCAE V5.0., Patient quality of life according to EORTC QLQC30 and items selected form the PRO CTC-AE, Translational program : TMB on tumor sample and ctDNA ; RNASeq and WES on pre and on-treatment tumor samples ; multi-IF or IHC (eg but not limited to PD-L1, TIGIT, LAG3, TIM3)

Source: https://euclinicaltrials.eu/ctis-public/view/2023-506291-28-00